EU clinical trial 2025-522306-21-00: Effectiveness of CITicoline (TRAUSAN) in preventing cognitive decline After DELirium in older adults with proximal hip fracture – The CITADEL randomized controlled trial
Protocol code: CITADEL
Sponsor: Universita Degli Studi Di Milano Bicocca (Educational Institution). Phase: Therapeutic exploratory (Phase II). Countries: Italy (authorised, recruitment pending).
Therapeutic area(s): Diseases [C] - Nervous System Diseases [C10]
Gender: Female, Male. Age: 65+ years. Enrolment: 122.
Status: Authorised, recruitment pending. Decision date: 2025-10-13. Results received: No. Last updated: 2025-10-13.

Condition(s): Cognitive profiles
Product: TRAUSAN 1000 mg soluzione orale

Primary endpoint: The Montreal Cognitive Assessment (MoCA) performed before discharge and at 6 months post-randomization will allow to assess the primary objective.
Endpoint(s): Montreal Cognitive Assessment (MoCA) performed before discharge and at 3 and 6months post-randomization, Short Physical Performance Battery (SPPB), performed at 3 and 6months post-randomization, Rates of adverse events (quantity/seriousness) during the 6-months follow-up after randomization

Source: https://euclinicaltrials.eu/ctis-public/view/2025-522306-21-00